EU clinical trial 2023-504773-20-00: An Open Label Single-Arm Phase 3 Study to Evaluate the Efficacy, Safety, Tolerability, Pharmacokinetics, and Immunogenicity of Vedolizumab Intravenous in the Treatment of Pediatric Subjects with Active Chronic Pouchitis
Protocol code: Vedolizumab-3041
Sponsor: Takeda Development Center Americas Inc. (Pharmaceutical company). Phase: Therapeutic confirmatory (Phase III). Countries: Czechia (ongoing, recruiting), Italy (ongoing, recruiting), Greece (authorised, recruiting), Denmark (not authorised), Croatia (ongoing, recruiting), Belgium (authorised, recruiting), Poland (authorised, recruiting), Spain (authorised, recruiting).
Therapeutic area(s): Diseases [C] - Digestive System Diseases [C06]
Gender: Female, Male. Age: 0-17 years. Enrolment: 26.
Start date (EU): 2024-08-01. Decision date: 2024-06-26. Results received: No. Last updated: 2026-07-08.
Decision dates by country: DK: 2024-07-02, CZ: 2024-07-03, HR: 2024-07-05, IT: 2024-06-26, GR: 2024-07-04, BE: 2024-06-27, PL: 2024-07-02, ES: 2024-07-02

Condition(s): Active Chronic Pouchitis
Product: RIFAXIMIN, VANCOMYCIN, CIPROFLOXACIN, AMOXICILLIN AND BETA-LACTAMASE INHIBITOR, Entyvio 300 mg powder for concentrate for solution for infusion, METRONIDAZOLE

Primary endpoint: 01. The primary efficacy endpoint is clinical (mPDAI) remission (defined as an mPDAI score <5 and a reduction of overall mPDAI score by ≥2 points from baseline) assessed at W14.
Endpoint(s): 01.Clinical (mPDAI) remission (defined as an mPDAI score <5 and a reduction of overall mPDAI score by ≥2 points from baseline) assessed at W34., 02. PDAI remission (defined as PDAI score <7 and a decrease in PDAI score by ≥3 points from baseline) at W14., 03. PDAI remisssion (defined as PDAI score <7 and a decrease in PDAI score by >3 points from baseline) at W34, 04. Clinical (mPDAI) response (defined as a decrease in mPDAI score by ≥2 points from baseline) at W14, 05. Clinical (mPDAI) response (defined as a decrease in mPDAI score by >2 points fom baseline) at W34., 06. Change from baseline in mPDAI clinical symptom subscore at W14., 07. Change from baseline in mPDAI total score at W34, 08. Change from baseline in PDAI total score and PDAI clinical symptoms, endoscopic, and histologic subscores at W14, 09. Change from baseline in PDAI total score and PDAI clinical symptoms, endoscopic and histologic subscores at W34., 10. Index scores, visual analogue scale (VAS), and changes from baseline for each in the EQ-5D-Y Proxy Version 1.0 at W14 and W34.

Source: https://euclinicaltrials.eu/ctis-public/view/2023-504773-20-00